EU clinical trial 2023-508591-11-00: FDG-PET/CT versus conventional CT for response monitoring in metastatic breast cancer: a multicenter randomized clinical trial (MONITOR-RCT)
Protocol code: 2023-508591-11-00
Sponsor: Odense University Hospital (Hospital/Clinic/Other health care facility). Phase: Therapeutic confirmatory (Phase III). Countries: Italy (ongoing, recruiting), Denmark (ongoing, recruiting), Germany (authorised, recruiting).
Therapeutic area(s): Diseases [C] - Neoplasms [C04]; Analytical, Diagnostic and Therapeutic Techniques and Equipment [E] - Diagnosis [E01]
Gender: Female, Male. Age: 18-64 years, 65+ years. Enrolment: 420.
Start date (EU): 2025-02-25. Decision date: 2024-10-14. Results received: No. Last updated: 2026-02-17.
Decision dates by country: DK: 2024-10-14, DE: 2024-10-14, IT: 2024-10-16

Condition(s): Metastatic breast cancer
Product: FLUDEOXYGLUCOSE (18F)

Primary endpoint: Overall survival
Endpoint(s): Quality of life, Time and exposure to oncologic treatment, Cost-effectiveness

Source: https://euclinicaltrials.eu/ctis-public/view/2023-508591-11-00